EU clinical trial 2025-522336-14-00: A study to learn how safe nurandociguat is when taken with sildenafil in men with arterial hypertension.
Protocol code: 22598
Sponsor: Bayer AG (Pharmaceutical company). Phase: Human Pharmacology (Phase I)- Other. Countries: Germany (authorised, recruitment pending).
Therapeutic area(s): Diseases [C] - Cardiovascular Diseases [C14]
Gender: Male. Age: 18-64 years. Enrolment: 36.
Status: Authorised, recruitment pending. Decision date: 2025-11-12. Results received: No. Last updated: 2026-07-17.

Condition(s): Chronic Kidney Disease, Arterial hypertension

Source: https://euclinicaltrials.eu/ctis-public/view/2025-522336-14-00